EU clinical trial 2024-519077-19-01: Contrast enhanced ultrasound a novel technique in lymphatic imaging - A prospective study
Sponsor: Kuopio University Hospital (Hospital/Clinic/Other health care facility). Phase: Phase II and Phase III (Integrated). Countries: Finland (authorised, recruitment pending).
Therapeutic area(s): Analytical, Diagnostic and Therapeutic Techniques and Equipment [E] - Diagnosis [E01]
Gender: Female, Male. Age: 18-64 years. Enrolment: 100.
Status: Authorised, recruitment pending. Decision date: 2024-12-04. Results received: No. Last updated: 2024-12-04.

Condition(s): Lymphatic Imaging
Product: Sonazoid 8 mikroliter per ml pulver og væske til injeksjonsvæske, dispersjon

Primary endpoint: Visualization of the superficial lymphatic vessels after the injection of the ultrasound contrast agent

Source: https://euclinicaltrials.eu/ctis-public/view/2024-519077-19-01